EU clinical trial 2022-500907-27-01: A superiority study comparing two pharmaceutical skin care creams containing different humectants with a non-humectant containing skin care cream for the treatment of xerotic foot of persons with diabetes.
Sponsor: Malmö Universitet (Educational Institution). Phase: Therapeutic use (Phase IV). Countries: Sweden (authorised, recruitment pending).
Therapeutic area(s): Diseases [C] - Skin and Connective Tissue Diseases [C17]
Gender: Female, Male. Age: 18-64 years, 65+ years. Enrolment: 1.
Status: Authorised, recruitment pending. Decision date: 2023-07-31. Results received: No. Last updated: 2025-06-25.

Condition(s): xerotic skin on foot of subjects with diabetes
Product: Oviderm, 250 mg/g, krem, Canoderm 5 % kräm

Primary endpoint: To demonstrate superiority of test products over a comparator in reducing xerosis on feet of subjects with diabetes by clinical assessment of the Xerosis Severity Scale from baseline until after 4 weeks treatment.
Endpoint(s): (1) Comparing the change in skin barrier integrity as demonstrated by the non-invasive biophysical measurements of trans epidermal water loss, skin hydration and skin pH between test products and comparator from baseline until 2 and 4 weeks of treatment. (2) Comparing the change in EQ-5D-5L between test products and comparator from baseline until after 4 weeks treatment. (3) Safety: Documentation and evaluation of adverse effects and assessing vital signs.

Source: https://euclinicaltrials.eu/ctis-public/view/2022-500907-27-01